EU clinical trial 2023-506911-16-00: A PHASE III RANDOMIZED, DOUBLE-BLIND, PLACEBO-CONTROLLED, MULTICENTER STUDY EVALUATING THE EFFICACY AND SAFETY OF GDC-9545 COMBINED WITH PALBOCICLIB COMPARED WITH LETROZOLE COMBINED WITH PALBOCICLIB IN PATIENTS WITH ESTROGEN RECEPTOR-POSITIVE, HER2-NEGATIVE LOCALLY ADVANCED OR METASTATIC BREAST CANCER
Protocol code: BO41843
Sponsor: F. Hoffmann-La Roche AG (Pharmaceutical company). Phase: Therapeutic confirmatory (Phase III). Countries: France (ongoing, recruitment ended), Germany (ongoing, recruitment ended), Italy (ongoing, recruitment ended), Portugal (ongoing, recruitment ended), Belgium (ongoing, recruitment ended), Denmark (ongoing, recruitment ended), Spain (ongoing, recruitment ended), Poland (ongoing, recruitment ended), Austria (ongoing, recruitment ended), Hungary (ended), Greece (ongoing, recruitment ended).
Therapeutic area(s): Diseases [C] - Neoplasms [C04]
Gender: Female, Male. Age: 18-64 years, 65+ years. Enrolment: 259.
Start date (EU): 2020-12-04. Decision date: 2024-03-27. Results received: No. Last updated: 2026-07-17.
Decision dates by country: PT: 2024-03-27, BE: 2024-04-12, PL: 2024-04-19, GR: 2024-05-13, IT: 2024-04-02, HU: 2024-03-27, DK: 2024-03-27, DE: 2024-03-27, AT: 2024-04-08, FR: 2024-04-12, ES: 2024-04-01

Condition(s): ESTROGEN RECEPTOR-POSITIVE, HER2-NEGATIVE LOCALLY ADVANCED OR METASTATIC BREAST CANCER
Product: IBRANCE 125 mg hard capsules, IBRANCE 100 mg hard capsules, RO7197597, IBRANCE 125 mg film-coated tablets, Placebo Giredestrant, Femara® 2,5 mg Filmtabletten, Placebo Letrozole, IBRANCE 75 mg hard capsules, IBRANCE 100 mg film-coated tablets, IBRANCE 75 mg film-coated tablets

Primary endpoint: 1. Progression-free survival (PFS
Endpoint(s): 1. Overall survival (OS), 2. Objective response rate (ORR), 3. Duration of response (DOR), 4. Clinical benefit rate (CBR), 5. Time to confirmed deterioration (TTCD) in pain level, 6. TTCD in pain presence and interference, 7. TTCD in physical functioning (PF), 8. TTCD in role functioning (RF), 9. TTCD in global health status (GHS) and quality-of-life (QoL), 10. Incidence and severity of adverse events, with severity determined according to National Cancer Institute (NCI) Common Terminology Criteria for Adverse Events, Version 5.0 (CTCAE v5.0), 11. Change from baseline in targeted vital signs, 12. Plasma concentration of GDC-9545 at specified timepoints, 13. Plasma concentration of palbociclib at specified timepoints

Source: https://euclinicaltrials.eu/ctis-public/view/2023-506911-16-00